EU clinical trial 2023-510333-28-00: EORTC 2022-MG: Adjuvant tebentafusp (IMCgp100) versus observation in HLA-A*02:01 positive patients following definitive treatment of high-risk uveal melanoma: an EORTC randomized phase III study (ATOM Trial)
Protocol code: EORTC 2022-MG
Sponsor: European Organisation For Research And Treatment Of Cancer (Patient organisation/association). Phase: Therapeutic confirmatory (Phase III). Countries: Germany (ongoing, recruiting), Spain (ongoing, recruiting), France (ongoing, recruiting), Poland (ongoing, recruiting), Italy (ongoing, recruiting), Belgium (ongoing, recruiting), Netherlands (ongoing, recruiting), Ireland (authorised, recruitment pending), Sweden (authorised, recruiting).
Therapeutic area(s): Diseases [C] - Eye Diseases [C11]
Gender: Female, Male. Age: 18-64 years, 65+ years. Enrolment: 200.
Start date (EU): 2025-08-20. Decision date: 2024-09-18. Results received: No. Last updated: 2026-07-10.
Decision dates by country: FR: 2024-09-20, DE: 2024-09-20, IE: 2025-09-19, NL: 2024-09-19, PL: 2024-09-22, ES: 2024-09-23, SE: 2025-09-25, IT: 2024-09-23, BE: 2024-09-18

Condition(s): Uveal Melanoma
Product: KIMMTRAK 100 micrograms/0.5 mL concentrate for solution for infusion

Primary endpoint: RFS, defined as time between randomization and local recurrence, distant recurrence, or death, whichever occurs first.
Endpoint(s): OS, defined as time between randomization and death, Safety of tebentafusp.

Source: https://euclinicaltrials.eu/ctis-public/view/2023-510333-28-00